EU clinical trial 2024-511005-39-00: Phase II/III double-blind randomized placebo-controlled trial assessing the preventive effect of Clopidogrel on the systemic sclerosis development risk in subjects with specific dysimmunity and Raynaud phenomenon - PSSIT
Protocol code: CHUBX 2017/45
Sponsor: Centre Hospitalier Universitaire De Bordeaux (Hospital/Clinic/Other health care facility). Phase: Phase II and Phase III (Integrated). Countries: France (ongoing, recruiting).
Therapeutic area(s): Phenomena and Processes [G] - Immune system processes [G12]
Gender: Female, Male. Age: 18-64 years, 65+ years. Enrolment: 90.
Status: Ongoing, recruiting. Start date (EU): 2022-06-22. Decision date: 2024-02-15. Results received: No. Last updated: 2026-07-01.

Condition(s): Raynaud phenomenon
Product: Plavix 75 mg film-coated tablets, PL1

Primary endpoint: Occurrence of SSc at 5 years according to ACR / EULAR 2013 criteria in the two randomization groups
Endpoint(s): Frequency of occurrence of cutaneous fibrosis (sclerodactyly or other affected area) clinically assessed by at least 2 independent investigators in the two randomization groups, Mean of modified Rodman skin score in the two randomization groups, Mean of Cochin Hand Function Scale in the two randomization groups, Demographic (sex, age, environmental factors), clinical (associated diseases, history), biological, capillaroscopic criteria in the two randomization groups

Source: https://euclinicaltrials.eu/ctis-public/view/2024-511005-39-00